EU clinical trial 2023-506514-44-00: A PLACEBO CONTROLLED, RANDOMIZED DOUBLE-BLIND PARALLEL GROUP 12-MONTH TRIAL OF FASUDIL FOR THE TREATMENT OF EARLY ALZHEIMER’S DISEASE (FEAD)
Sponsor: Helse Stavanger HF (Hospital/Clinic/Other health care facility). Phase: Therapeutic exploratory (Phase II). Countries: Norway (ongoing, recruiting).
Therapeutic area(s): Diseases [C] - Nervous System Diseases [C10]
Gender: Female, Male. Age: 18-64 years, 65+ years. Enrolment: 200.
Status: Ongoing, recruiting. Start date (EU): 2024-06-11. Decision date: 2024-02-20. Results received: No. Last updated: 2026-06-09.
Decision dates by country: NO: 2024-04-19

Condition(s): Alzheimer's disease
Product: Placebo capsule to match 20 mg fasudil, Placebo capsule to match 40 mg fasudil, Fasudil Hyrdrochloride, Fasudil Hydrochloride

Primary endpoint: The primary outcome will be the FLAME computer-based working memory composite, specifically the change over 12 months
Endpoint(s): Using FLAME battery to assess speed of attention, accuracy of attention and executive function, Measure the extension and severity of the AD hypometabolic pattern at FDG-PET, Safety data will be collected through measurements of vital signs, weight, physical and neurological examination, clinical safety laboratory tests, ECG, and suicidality, Changes in CSF Aβ1-40, Aβ1-42, tau and p-tau and blood plasma ptau217, Nfl and other relevant markers of neurodegeneration will be assessed over 12 months., Ability to perform everyday activities, and changes in functionality: Activities of daily living assessments using the Amsterdam ADL scale, Overall clinical condition: Clinical Global Impression of Change, Severity of dementia symptoms: Clinical Dementia Rating (CDR)-sum of boxes, Neuropsychiatric symptoms and behaviors Neuropsychiatric Inventory (NPI-Q), Quality of life assessments using the DEMQOL and a short assessment of health-related costs using the EQ-5D questionnaire

Source: https://euclinicaltrials.eu/ctis-public/view/2023-506514-44-00